EU clinical trial 2023-509663-24-00: SAKK 01/18: Reduced intensity radio-chemotherapy for Stage IIA/B seminoma. A multicenter, open label phase II trial with two cohorts
Protocol code: SAKK 01/18
Sponsor: Swiss Group for Clinical Cancer Research (Patient organisation/association). Phase: Therapeutic exploratory (Phase II). Countries: Germany (ongoing, recruitment ended).
Therapeutic area(s): Diseases [C] - Neoplasms [C04]
Gender: Male. Age: 18-64 years, 65+ years. Enrolment: 95.
Status: Ongoing, recruitment ended. Start date (EU): 2020-08-20. Decision date: 2024-08-12. Results received: No. Last updated: 2026-07-31.

Condition(s): Stage IIA/B seminoma
Product: Carboplat onkovis 10 mg/ml Konzentrat zur Herstellung einer Infusionslösung, Etomedac 20 mg/ml Konzentrat zur Herstellung einer Infusionslösung, Cisplatin NeoCorp 1 mg/ml - Konzentrat zur Herstellung einer Infusionslösung

Primary endpoint: Progression free survival (PFS) at 3 years
Endpoint(s): Response rate (RR), Progression free survival (PFS), Time to progression (TTP), Overall Survival (OS), Seminoma-specific survival, Time to distant metastasis, Time to next treatment, Localization of progression, Method of detection of progression

Source: https://euclinicaltrials.eu/ctis-public/view/2023-509663-24-00